EU clinical trial 2024-518199-30-00: Phase I-II prospective trial, multicenter, open label, exploring the combination of Trabectedin plus RAdiotherapy in Soft Tissue Sarcoma patients
Sponsor: Asoc Grupo Espanol De Investigacion En Sarcomas (Patient organisation/association). Phase: Phase I and Phase II (Integrated)- Other. Countries: Italy (authorised, recruitment pending), Spain (authorised, recruitment pending), France (authorised, recruitment pending).
Therapeutic area(s): Diseases [C] - Neoplasms [C04]
Gender: Female, Male. Age: 18-64 years, 65+ years. Enrolment: 163.
Status: Authorised, recruitment pending. Decision date: 2024-11-25. Results received: No. Last updated: 2026-08-06.
Decision dates by country: IT: 2024-12-02, FR: 2024-11-27, ES: 2024-11-25

Condition(s): Soft tissue sarcoma patients
Product: Yondelis 1 mg powder for concentrate for solution for infusion.

Primary endpoint: To determine the maximum tolerated dose (MTD) or the recommended phase II dose of trabectedin for the combination with radiation therapy. RECIST response for the combination of trabectedin plus radiation therapy in cohorts A, B. CHOI response for the combination of trabectedin plus radiation therapy in cohort C. In cohort D to improve 5-year relapse-free survival (RFS), decreasing the 5-year relapse percentage from 30% to 10% in cohort D patients.

Source: https://euclinicaltrials.eu/ctis-public/view/2024-518199-30-00